EU clinical trial 2022-501246-30-00: A multi-center, double-blind, randomized, placebo-controlled, 2-way cross-over post approval study to investigate the efficacy of daridorexant in subjects with insomnia and comorbid nocturia
Protocol code: ID-078A401
Sponsor: Idorsia Pharmaceuticals Ltd. (Pharmaceutical company). Phase: Therapeutic use (Phase IV). Countries: Spain (ended), Germany (ended).
Therapeutic area(s): Diseases [C] - Nervous System Diseases [C10]
Gender: Female, Male. Age: 18-64 years, 65+ years. Enrolment: 35.
Status: Ended. Start date (EU): 2023-03-08. End date (EU): 2024-04-17. End date: 2024-04-18. Decision date: 2023-03-02. Results received: Yes. Last updated: 2023-12-04.
Decision dates by country: ES: 2023-03-06, DE: 2023-03-02

Condition(s): Insomnia Disorder, Nocturia
Product: daridorexant placebo matching film-coated tablets, QUVIVIQ 50 mg film-coated tablets

Primary endpoint: Change from baseline to Week 4 in subjective total sleep time (sTST).

Source: https://euclinicaltrials.eu/ctis-public/view/2022-501246-30-00